EU clinical trial 2024-517269-18-00: Randomized trial of standard chemotherapy alone or combined with atezolizumab as adjuvant therapy for patients with stage III colon cancer and deficient DNA mismatch repair (ATOMIC)
Protocol code: A021502
Sponsor: National Cancer Institute, AIO-Studien gGmbH (Laboratory/Research/Testing facility). Phase: Therapeutic confirmatory (Phase III). Countries: Germany (ongoing, recruiting).
Therapeutic area(s): Diseases [C] - Neoplasms [C04]
Gender: Female, Male. Age: 18-64 years, 65+ years. Enrolment: 28.
Status: Ongoing, recruiting. Start date (EU): 2024-09-18. Decision date: 2024-09-18. Results received: No. Last updated: 2025-10-17.

Condition(s): stage III colon adenocarcinoma with deficient MMR
Product: FLUOROURACIL, Tecentriq 1 200 mg concentrate for solution for infusion, CALCIUM FOLINATE PENTAHYDRATE, OXALIPLATIN

Primary endpoint: Disease-free survival (DFS), defined as the time from randomization to first documentation of disease recurrence (primary tumor relapse) or death.

Source: https://euclinicaltrials.eu/ctis-public/view/2024-517269-18-00